EU clinical trial 2023-506260-14-00: A Phase 2, Open-label, Randomized Study to Evaluate GPRC5D-related Oral Events
Protocol code: 64407564MMY2006
Sponsor: Janssen - Cilag International (Pharmaceutical company). Phase: Therapeutic exploratory (Phase II). Countries: Spain (ongoing, recruiting), Netherlands (ongoing, recruiting).
Therapeutic area(s): Diseases [C] - Neoplasms [C04]
Gender: Female, Male. Age: 18-64 years, 65+ years. Enrolment: 57.
Status: Ongoing, recruiting. Start date (EU): 2025-05-13. Decision date: 2024-07-22. Results received: No. Last updated: 2026-07-28.
Decision dates by country: ES: 2024-07-22, NL: 2024-08-16

Condition(s): multiple myeloma
Product: Pregabalin-ratiopharm® 25 mg Hartkapseln, Clonazepam Orally Disintegrating Tablets, USP, Protopic 0.1% ointment, Clonazepam Orally Disintegrating Tablets, USP, Clonazepam Orally Disintegrating Tablets, USP, JNJ-79635322, Clonazepam Orally Disintegrating Tablets, USP, DEXAMETHASONE ELIXIR, USP, Clonazepam Orally Disintegrating Tablets, USP, JNJ-64407564, JNJ-64407564, Clonazepam Orally Disintegrating Tablets, USP, JNJ-79635322, Clonazepam Orally Disintegrating Tablets, USP, Pregabalin-ratiopharm® 50 mg Hartkapseln, Clonazepam Orally Disintegrating Tablets, USP, Clonazepam Orally Disintegrating Tablets, USP

Primary endpoint: As determined by the total WETT testing score: - Rate of occurrence of taste dysfunction dysgeusia - Rate of occurrence of severe dysgeusia - Time to the first onset of severe dysgeusia - Rate of resolution/improvement of dysgeusia at the end of Months 3 and 7

Source: https://euclinicaltrials.eu/ctis-public/view/2023-506260-14-00